EU clinical trial 2024-514846-35-00: An Open-label, Long-term Extension Study to Evaluate Safety and Efficacy of Atumelnant in Participants with Congenital Adrenal Hyperplasia
Protocol code: CRN04894-09
Sponsor: Crinetics Pharmaceuticals Inc. (Pharmaceutical company). Phase: Therapeutic exploratory (Phase II). Countries: Italy (ongoing, recruiting), Germany (ongoing, recruiting).
Therapeutic area(s): Diseases [C] - Hormonal diseases [C19]; Diseases [C] - Congenital, Hereditary, and Neonatal Diseases and Abnormalities [C16]
Gender: Female, Male. Age: 18-64 years, 65+ years. Enrolment: 8.
Status: Ongoing, recruiting. Start date (EU): 2025-07-22. Decision date: 2025-03-26. Results received: No. Last updated: 2026-07-01.
Decision dates by country: IT: 2025-03-27, DE: 2025-03-26

Condition(s): CONGENITAL ADRENAL HYPERPLASIA
Product: Atumelnant 80 mg tablets, Atumelnant 120 mg tablets, Atumelnant 40 mg tablet

Primary endpoint: Safety Endpoints: Incidence of treatment-emergent adverse events (TEAEs), including treatment-emergent serious adverse events (SAEs), adverse events of special interest (AESI [adrenal insufficiency]) and any adverse events (AEs) leading to discontinuation Incidence of glucocorticoid (GC) deficiency/adrenal insufficiency and adrenal crisis Incidence of hospitalizations related to congenital adrenal hyperplasia (CAH) Efficacy Endpoint: Change from baseline in morning serum A4 over time
Endpoint(s): Secondary Efficacy Endpoints Change from baseline in morning (before 11:00 AM) serum 17-OHP over time Change from baseline in daily GC dose (hydrocortisone [HC] mg equivalents body surface area [BSA] adjusted) over time

Source: https://euclinicaltrials.eu/ctis-public/view/2024-514846-35-00